EU clinical trial 2023-510389-28-00: An Open-label Extension Trial to Evaluate the Long-term Safety of Apraglutide in Short Bowel Syndrome. (STARS extend)
Protocol code: TA799-012
Sponsor: VectivBio AG (Pharmaceutical company). Phase: Therapeutic confirmatory (Phase III). Countries: Spain (ongoing, recruitment ended), Denmark (ongoing, recruitment ended), Norway (ended), Germany (ongoing, recruitment ended), France (ongoing, recruitment ended), Sweden (ongoing, recruitment ended), Hungary (ongoing, recruitment ended), Belgium (ongoing, recruitment ended), Poland (ongoing, recruitment ended), Italy (ongoing, recruitment ended), Czechia (ongoing, recruitment ended).
Therapeutic area(s): Diseases [C] - Digestive System Diseases [C06]
Gender: Female, Male. Age: 18-64 years, 65+ years. Enrolment: 101.
Start date (EU): 2021-06-14. Decision date: 2024-07-08. Results received: No. Last updated: 2026-06-08.
Decision dates by country: PL: 2024-08-04, FR: 2024-07-09, NO: 2024-07-08, BE: 2024-07-08, DE: 2024-07-09, SE: 2024-07-09, CZ: 2024-07-10, HU: 2024-07-08, DK: 2024-07-08, ES: 2024-07-08, IT: 2024-07-15

Condition(s): short bowel syndrome
Product: Apraglutide

Primary endpoint: 1. Adverse events (AEs; system organ class, frequency and severity), 2. Occurrence of clinically relevant AEs of special interest (AESIs): o Injection site reactions o Gastrointestinal (GI) obstructions o Gallbladder, biliary and pancreatic disease o Fluid overload o Colorectal polyps o Malignancies, 3. Clinical chemistry, hematology, hemostasis and urinalysis, 4. Occurrence of clinically relevant changes in vital signs (systolic and diastolic blood pressure, heart rate), 5. Occurrence of clinically relevant changes in electrocardiogram (ECG; intervals and rhythm)
Endpoint(s): 1. Change from baseline in PS volume at Weeks 52, 104, 152, 216, 264 and 312, 2. Change from baseline in PS frequency at Weeks 52, 104, 152, 216, 264 and 312, 3. Change from baseline in PS composition at Weeks 52, 104, 152, 216, 264 and 312, 4. Change from baseline in PS infusion time at Weeks 52, 104, 152, 216, 264 and 312, 5. Percentage of subjects reaching enteral autonomy by Weeks 52, 104, 152, 216, 264 and 312, 6. Change from baseline in body weight at Weeks 52, 104, 152, 216, 264 and 312, 7. Change from baseline on the Pittsburgh Sleep Quality Index (PSQI) at Weeks 52, 104, 152, 216, 264 and 312, 8. Change from baseline on the Patient Global Impression of Change (PGIC) at Weeks 52, 104, 152, 216, 264 and 312, 9. Change from baseline on the Patient Global Impression of Severity (PGIS) at Weeks 52, 104, 152, 216, 264 and 312, 10. Changes from baseline on Patient Global Impression of Treatment Satisfaction (PGI-TS) at Weeks 52, 104, 152, 216, 264 and 312, 11. Changes from baseline on Patient Global Impression of Satisfaction with Parenteral Support (PGI-SPS) at Weeks 52, 104, 152, 216, 264 and 312, 12. Changes from baseline on Patient Global Impression of Parenteral Support Impact (PGI-PSI) at Weeks 52, 104, 152, 216, 264 and 312, 13. Change from baseline on the Short Form (36) Health Survey (SF-36) at Weeks 52, 104, 152, 216, 264 and 312, 14. Change from baseline on the EuroQoL-5 dimension - 5 level survey (EQ-5D-5L) at Weeks 52, 104, 152, 216, 264 and 312

Source: https://euclinicaltrials.eu/ctis-public/view/2023-510389-28-00